EU clinical trial 2025-521849-25-00: A Phase 2, Randomized, Open-Label Study Of Axatilimab Versus Best Available Therapy in Pediatric Participants With Chronic Graft Versus Host Disease After at Least 2 Prior Lines of Systemic Therapy (AGAVE-256)
Protocol code: INCA034176-256
Sponsor: Incyte Corp. (Pharmaceutical company). Phase: Therapeutic exploratory (Phase II). Countries: Spain (authorised, recruiting), Belgium (authorised, recruiting), Germany (authorised, recruiting), Italy (ongoing, recruiting).
Therapeutic area(s): Diseases [C] - Immune System Diseases [C20]
Gender: Female, Male. Age: 0-17 years. Enrolment: 42.
Start date (EU): 2026-02-17. Decision date: 2025-10-17. Results received: No. Last updated: 2026-06-25.
Decision dates by country: IT: 2025-10-22, DE: 2025-10-22, BE: 2025-10-23, ES: 2025-10-22

Condition(s): Chronic Graft-Versus-Host Disease
Product: Axatilimab (INCA034176)

Primary endpoint: OR at 6 months, defined for each treatment group as CR or PR at 6 months (C7D1) in the absence of new systemic therapy for cGVHD.
Endpoint(s): Axatilimab PK parameters, including Cmax, tmax, Cmin, AUC0 t, AUC0-∞, CL, Vz, and t½, as deemed appropriate., • BOR defined as best response of CR or PR in the first 6 months (up to and including C7D1), and at any timepoint up to the initiation of new systemic therapy for cGVHD., • OR at 12 months, defined as CR or PR at 12 months in the absence of new systemic therapy for cGVHD., • DOR (in responders only), defined as the time from the date of first response (PR or CR) to the date of progression of cGVHD, initiation of new systemic treatment for cGVHD, or death from any cause, whichever comes first., • Organ-specific response., Percent reduction in daily corticosteroid dose at C7D1, and participants successfully tapered off all corticosteroids at C7D1., Changes in parameters collected using the pediatric stem cell QoL questionnaire (PedsQL Stem Cell Transplant Module), Safety and tolerability will be assessed by evaluating the frequency and severity of AEs (including SAEs), including changes in clinical assessments, laboratory assessments, Tanner stage, and KPS/LPS scores.

Source: https://euclinicaltrials.eu/ctis-public/view/2025-521849-25-00